EU clinical trial 2024-514304-14-00: Comparison between ABP 234 and Keytruda® (Pembrolizumab)
Protocol code: 20210033
Sponsor: Amgen Inc. (Pharmaceutical company). Phase: Human Pharmacology (Phase I)- First administration to humans. Countries: Bulgaria (ongoing, recruiting), Spain (ongoing, recruiting), Poland (ongoing, recruiting), Italy (ongoing, recruiting), Germany (ended), France (ongoing, recruiting), Austria (ended).
Therapeutic area(s): Diseases [C] - Respiratory Tract Diseases [C08]
Gender: Female, Male. Age: 18-64 years, 65+ years. Enrolment: 233.
Start date (EU): 2024-10-08. Decision date: 2024-09-25. Results received: No. Last updated: 2026-07-20.
Decision dates by country: AT: 2025-02-10, DE: 2024-09-27, IT: 2024-09-25, BG: 2024-09-30, PL: 2024-09-30, FR: 2024-09-27, ES: 2024-09-25

Condition(s): Advanced or Metastatic Non-squamous Non-Small Cell Lung Cancer

Source: https://euclinicaltrials.eu/ctis-public/view/2024-514304-14-00